EU clinical trial 2025-521030-29-00: Pomalidomide in people with chronic hepatitis B virus (HBV) infection: Safety and immune-enhancing effects (The PIPPI Study)
Protocol code: 001
Sponsor: Region Midtjylland (Hospital/Clinic/Other health care facility). Phase: Phase I and Phase II (Integrated)- Other. Countries: Denmark (ongoing, recruiting).
Therapeutic area(s): Diseases [C] - Virus Diseases [C02]
Gender: Female, Male. Age: 18-64 years, 65+ years. Enrolment: 14.
Status: Ongoing, recruiting. Start date (EU): 2025-08-19. Decision date: 2025-05-21. Results received: No. Last updated: 2026-03-12.

Condition(s): Hepatitis B virus infection
Product: Pomalidomide

Primary endpoint: Safety defined as treatment-emerging adverse events (AEs) = or > grade 3 probably or definitely related to pomalidomide., Safety defined as all other treatment-emerging AEs, graded according to severity and assessed as either not related or possibly, probably or definitely related to pomalidomide
Endpoint(s): Quantitative plasma levels of HBV DNA, Quantitative plasma levels of HBsAg, Serum titres of anti-HBs and anti-HBe, Levels of the liver function tests (LFTs) including ALT, bilirubin and PP, Numbers, proportions and subset distribution of NK cells including changes in the proportion of cytotoxic and dysfunctional NK cells as determined by expression of CD56, CD16, activating and inhibitory markers using flow cytometry, The frequency of CD4 and/or CD8 T-cell responses to HBV peptides measured either by intracellular cytokine staining (ICS), activation induced marker (AIM) assay or by ELISPOT and the proportion of polyfunctional CD8+ T cells

Source: https://euclinicaltrials.eu/ctis-public/view/2025-521030-29-00